EU clinical trial 2024-515395-12-00: Randomized, placebo-controlled clinical trial to investigate the safety and efficacy of two dexamfetamine sulfate formulations in adults with ADHD and moderate to severe depression (DEXAD)
Protocol code: TMP-18122023-58
Sponsor: Fraunhofer Institute For Translational Medicine And Pharmacology ITMP (Laboratory/Research/Testing facility). Phase: Therapeutic exploratory (Phase II). Countries: Germany (ongoing, recruiting).
Therapeutic area(s): Psychiatry and Psychology [F] - Behavior and Behavior Mechanisms [F01]; Psychiatry and Psychology [F] - Mental Disorders [F03]
Gender: Female, Male. Age: 18-64 years. Enrolment: 105.
Status: Ongoing, recruiting. Start date (EU): 2025-05-22. Decision date: 2025-02-03. Results received: No. Last updated: 2026-05-21.

Condition(s): Adults with ADHD and moderate to severe depression
Product: Placebo of Dexamfetamine sulfate 20 mg modified-release capsule, Dexamfetamine sulfate 20 mg modified-release capsule, Attentin 5 mg, Tablette, Dexamfetamine sulfate 15 mg modified-release capsule, Dexamfetamine sulfate 10 mg modified-release capsule, Placebo of Attentin 5 mg 10 mg tablets, Placebo of Dexamfetamine sulfate 15 mg modified-release capsule, Attentin 10 mg Tablette, Placebo of Dexamfetamine sulfate 10 mg modified-release capsule

Primary endpoint: Incidence of adverse events (AE) in the active treatment groups (DEX XL and DEX IR) compared to the placebo until V6
Endpoint(s): Incidence of adverse events (AE) until V5, Proportion of patients with at least one AE until V5 and until end of study, Number of AE until V5 and until end of study, Number of AE/SAE during the study period, number and proportion of patients with AE/SAE by type, severity (mild, moderate, severe) and relatedness to treatment, Score of CGI Efficacy index by investigator at Visit 5, MADRS suicidal ideation score (range 0-6) for all available visits (SCR to V5) and change to BL/V0 (only V1 to V5), Rate of patients with score 1-3 in CGI-I at V5, Absolute scores categories of CGI-I at all available visits (V1 to V5), Numbers and percentages of patients with (1) decreased, (2) maintained and (3) increased CGI-S at V5 compared to BL/V0, Shift table of CGI-S score categories at BL/V0, V1 and V5, Absolute score categories of CGI-S at all available visits (V0 to V5), MADRS total score (range 0-60) for all available visits (SCR to V5) and change to BL/V0 (only V1 to V5), MADRS total score categorization by Müller et al. (39) at BL/ V0, V1 and V5 (0-6 absence of symptoms; 7-19 mild depression, 20-34 moderate depression, 35-60 indicate a severe depression), ADHS-DC-Q total score (range 0-66) for all available visits (SCR to V5) and change to BL/V0 (only V1 to V5), QIDS-SR-16 total score (range 0-27) for all available visits (V0 to V5) and change to BL/V0 (only V1 to V5), Mean dose intake from V1 to V5 per treatment group, Mean dose intake compared to planned dose after titration phase (for study period V1 to V5) per treatment group, Proportion of patients with less than 80% of planned dose intake (for study period V1 to V5) per treatment group, Number and proportion of patients by dosage group (DEX IR: 10 mg, 15 mg, 20 mg, 30 mg; DEX XL: 10 mg, 15 mg, 20 mg, 30 mg; Placebo: 10 mg, 15 mg, 20 mg, 30 mg)) at V1 and V2, Number and proportion of patients per treatment group that needed dose optimization of IMP in the optimal stable dose phase and type of optimization (e.g., downtitration), Number and percentage of patients with early withdrawal from therapy due to adverse events - in total and per treatment group

Source: https://euclinicaltrials.eu/ctis-public/view/2024-515395-12-00